EU clinical trial 2023-504374-38-00: A Phase III, Randomized, Double blind, Placebo controlled, Multi centre, Global Study of Volrustomig in Women with High Risk Locally Advanced Cervical Cancer Who Have Not Progressed Following Platinum based, Concurrent Chemoradiation Therapy (eVOLVE Cervical)
Protocol code: D7984C00002
Sponsor: AstraZeneca AB (Pharmaceutical company). Phase: Therapeutic confirmatory (Phase III). Countries: Poland (ongoing, recruiting), Italy (ongoing, recruiting), Norway (ongoing, recruiting), Denmark (ongoing, recruiting), Germany (ongoing, recruiting), Spain (ongoing, recruiting).
Therapeutic area(s): Diseases [C] - Neoplasms [C04]
Gender: Female. Age: 0-17 years, 18-64 years, 65+ years. Enrolment: 101.
Status: Ongoing, recruiting. Start date (EU): 2024-04-12. Decision date: 2024-03-04. Results received: No. Last updated: 2026-08-05.
Decision dates by country: NO: 2024-03-08, DE: 2024-06-05, PL: 2024-03-08, IT: 2024-03-11, DK: 2024-03-04, ES: 2025-04-15

Condition(s): Locally advanced cervical cancer
Product: volrustomig, Remsima 100 mg powder for concentrate for solution for infusion, Saline, Mycofit, 250 mg, kapsułki twarde

Primary endpoint: Progression-free Survival (PFS) based on the investigator assessment in all randomized participants (FAS)., PFS is defined as the time from date of randomization until RECIST 1.1- defined radiological progression or histopathologically confirmed progression as assessed by the Investigator or death due to any cause, whichever occurs earlier., Up to approximately 7 years
Endpoint(s): Overall Survival (OS) in all randomized participants. OS defined as time from randomization until the date of death due to any cause., Objective Response Rate (ORR) in all randomized participants. ORR is defined as the proportion of participants who have a CR or PR, as determined by the Investigator per RECIST 1. 1., Duration of Response (DoR) in all randomized participants. DoR in participants with a CR or PR: Time from the date of first detection of CR or PR until the date of RECIST 1. 1- defined radiological progression or histopathologically confirmed progression., Time to First Subsequent Therapy or death (TFST) in all randomized participants. TFST: The time from randomization until the start date of the first subsequent anti-cancer therapy after discontinuation of randomized treatment, or death due to any cause., Time to second progression or death (PFS2) in all randomized participants. PFS2: The time from randomization to the earliest of the progression event (following the initial Investigator-assessed progression), after the first subsequent therapy, or death. The date of the second progression will be recorded by the Investigator in the eCRF and defined according to local standard clinical practice., PFS by BICR in all randomized participants. Endpoints based on the PFS by BICR assessment according to RECIST 1.1., The incidence of local progression, and distant disease progression as the first documented progression event in all randomized participants. Incidence of Local Progression, and Distant Disease Progression: Number and percentage of participants who develop local progression, distant disease recurrence., PK of volrustomig The concentration of volrustomig in serum and PK parameters., The immunogenicity of volrustomig. Incidence of ADAs against volrustomig in serum., Safety and tolerability profile of volrustomig compared to placebo. AEs, clinical laboratory assessments, vital signs, and electrocardiograms., Participant-reported disease-related symptoms. Change from baseline as measured by the EORTC IL318 (Symptom Experience subscale of the EORTC QLQ-CX24)., Participant reported physical functioning Change from baseline of physical functioning as measured by the PROMIS SF-PF Sc 7-day., Participant-reported global health status/QoL. Change from baseline of GHS/QoL as measured by the EORTC Ill 72., Up to approximately 7 years

Source: https://euclinicaltrials.eu/ctis-public/view/2023-504374-38-00